EU clinical trial 2023-506868-14-00: A Multicenter, Open-Label Phase 1/2 Trial Evaluating the Safety, Tolerability, and Efficacy of MORAb-202, a folate receptor alpha (FRα)-targeting antibody-drug conjugate (ADC) in Subjects With Selected Tumor Types
Protocol code: MORAb-202-G000-201
Sponsor: Eisai Limited (Pharmaceutical company). Phase: Phase I and Phase II (Integrated)- Other. Countries: France (ended), Spain (ongoing, recruiting).
Therapeutic area(s): Diseases [C] - Neoplasms [C04]
Gender: Female, Male. Age: 18-64 years, 65+ years. Enrolment: 90.
Start date (EU): 2023-02-28. Decision date: 2024-02-09. Results received: No. Last updated: 2025-12-29.
Decision dates by country: FR: 2024-02-09, ES: 2024-06-06

Condition(s): Solid tumors in 4 tumor types: platinum resistant ovarian cancer, triple-negative breast cancer (TNBC), endometrial cancer (EC), and non-small cell lung cancer adenocarcinoma; NSCLC).
Product: farletuzumab ecteribulin, LENVIMA 4 mg hard capsules, LENVIMA 10 mg hard capsules

Primary endpoint: RP2D of MORAb-202 (Dose-Escalation Part only).For Dose Optimization Part B: RD of MORAb-202 IV monotherapy and in combination with Lenvatinib., ORR: defined as the proportion of subjects achieving a best overall response (BOR) of complete response (CR) or partial response (PR) (BOR - are CR, PR, SD, PD, and not evaluable (NE), where SD has to be achieved at ≥5 weeks after the first dose. All responses of CR and PR must be confirmed no less than 28 days following the initial achievement of the response., Safety Endpoints: DLTs, AEs,(SAEs, AEs leading to treatment discontinuation),AEs leading to dose interruption/reduction and AEIs (including ILD incidence, severity, duration and outcome, and deaths).
Endpoint(s): DOR, DCR, CBR, PFS by RECIST 1.1, and OS. Safety Endpoints: clinical laboratory tests, vital signs, oxygen saturation, body weight, 12-lead ECGs, ECOG PS, and The PK profiles of MORAb-202/total antibody/released eribulin in serum or plasma. The relationship between FRA expression levels in tumor tissue and clinical outcome.

Source: https://euclinicaltrials.eu/ctis-public/view/2023-506868-14-00